EU clinical trial 2024-515606-90-00: A Phase 3 Open-label Study Evaluating the Long term Safety and Efficacy of Elexacaftor/Tezacaftor/Ivacaftor Triple Combination Therapy in Cystic Fibrosis Subjects 2 Years and Older
Protocol code: VX20-445-112
Sponsor: Vertex Pharmaceuticals Inc. (Pharmaceutical company). Phase: Therapeutic confirmatory (Phase III). Countries: Germany (ended).
Therapeutic area(s): Diseases [C] - Respiratory Tract Diseases [C08]
Gender: Female, Male. Age: 0-17 years. Enrolment: 3.
Status: Ended. Start date (EU): 2022-04-01. End date (EU): 2026-01-14. End date: 2026-01-29. Decision date: 2024-08-29. Results received: Yes. Last updated: 2025-08-19.

Condition(s): Cystic Fibrosis
Product: VX-445/VX-661/VX-770 fixed-dose combination granules, VX-445/VX-661/VX-770 fixed-dose combination granules, Kalydeco 75 mg granules in sachet, Kalydeco 75 mg film-coated tablets, VX-770 75mg, VX-770 granules, Kaftrio 37.5 mg/25 mg/50 mg film-coated tablets, Kaftrio 75 mg/50 mg/100 mg film-coated tablets, Kalydeco 150 mg film-coated tablets

Primary endpoint: Safety and tolerability of ELX/TEZ/IVA based on adverse events (AEs), clinical laboratory values, standard 12-lead ECGs, vital signs, and pulse oximetry
Endpoint(s): Absolute change in sweat chloride (SwCl), Absolute change in lung clearance index (LCI)2.5

Source: https://euclinicaltrials.eu/ctis-public/view/2024-515606-90-00